EU clinical trial 2023-507344-36-01: A Multicenter, Open-label, Phase 2 study of Intratumoral Vidutolimod (CMP-001) in Combination with Intravenous Cemiplimab in Subjects with Selected Types of Advanced or Metastatic Cancer
Protocol code: CMP-001-009
Sponsor: Regeneron Pharmaceuticals Inc. (Pharmaceutical company). Phase: Therapeutic exploratory (Phase II). Countries: France (ended).
Therapeutic area(s): Diseases [C] - Neoplasms [C04]
Gender: Female, Male. Age: 18-64 years, 65+ years. Enrolment: 26.
Status: Ended. End date (EU): 2024-06-14. End date: 2024-10-31. Decision date: 2024-01-30. Results received: Yes. Last updated: 2024-01-30.

Condition(s): Advanced or Metastatic Cancer; Merkel Cell Carcinoma (MCC); Cutaneous Squamous Cell Carcinoma (CSCC); Basal Cell Carcinoma (BCC); Triple Negative Breast Cancer (TNBC); Non-Small Cell Lung Cancer (NSCLC)
Product: LIBTAYO 350 mg concentrate for solution for infusion., Vidutolimod, Vidutolimod

Primary endpoint: ORR, defined as the proportion of subjects with a confirmed objective response of complete response (CR) or partial response (PR) based on Response Evaluation Criteria in Solid Tumors version 1.1 (RECIST v1.1) by investigator assessment
Endpoint(s): Adverse events (AEs), serious adverse events (SAEs), and AEs leading to discontinuation or death, and severity of AEs as assessed by the National Cancer Institute (NCI) Common Terminology Criteria for Adverse Events Version 5.0 (CTCAE v5.0), Duration of response (DOR), defined as the time from date of first documented response (CR or PR) to date of documented progressive disease (PD), based on RECIST v1.1, per investigator, Progression free survival (PFS), defined as the time from date of first dose of study treatment to date of documented PD based on RECIST v1.1 or death, whichever occurs first, Response in injected and noninjected target lesions per RECIST v1.1, Overall survival (OS), defined as the time from date of first dose of study treatment to date of death

Source: https://euclinicaltrials.eu/ctis-public/view/2023-507344-36-01